EU clinical trial 2024-515607-19-00: A Phase I study to evaluate the safety and dosimetry of 68Ga-OncoCAIX in patients with CAIX-positive cancer
Protocol code: PH-CAIXGA-02/24
Sponsor: Philogen S.p.A. (Pharmaceutical company). Phase: Human Pharmacology (Phase I)- First administration to humans. Countries: Italy (ended).
Therapeutic area(s): Diseases [C] - Neoplasms [C04]
Gender: Female, Male. Age: 18-64 years, 65+ years. Enrolment: 20.
Status: Ended. Start date (EU): 2025-03-19. End date (EU): 2025-11-28. Decision date: 2024-11-27. Results received: No. Last updated: 2024-11-27.

Condition(s): Patients with suspected clear cell renal cell carcinoma (ccRCC)

Source: https://euclinicaltrials.eu/ctis-public/view/2024-515607-19-00